EU clinical trial 2023-507660-39-00: EVALUATION OF THE EFFICACY AND SAFETY OF METFORMIN IN THE MYOTONIC DYSTROPHY TYPE I (STEINERT’S DISEASE). PHASE III PROSPECTIVE, MULTICENTRE, RANDOMISED, DOUBLE-BLIND CONTROLLED STUDY.
Protocol code: APHP220832
Sponsor: Assistance Publique Hopitaux De Paris (Hospital/Clinic/Other health care facility). Phase: Therapeutic confirmatory (Phase III). Countries: France (ongoing, recruiting).
Therapeutic area(s): Diseases [C] - Nervous System Diseases [C10]; Diseases [C] - Musculoskeletal Diseases [C05]
Gender: Female, Male. Age: 18-64 years, 65+ years. Enrolment: 203.
Status: Ongoing, recruiting. Start date (EU): 2024-12-03. Decision date: 2024-06-24. Results received: No. Last updated: 2026-06-26.

Condition(s): Myotonic dystrophy type 1 (DM1)
Product: METFORMINE VIATRIS 500 mg, comprimé dispersible, placebo of metformine

Primary endpoint: The primary endpoint is the evolution of the MFM-32 (Motor Function Measure) scale scoring between the baseline visit and the final visit at 12 months.
Endpoint(s): To evaluate the safety of metformin in DM1 patient using the collection of serious adverse event during the 12 months of treatment., To evaluate the efficacy on metformin on muscle function at 6 months using the evolution of MFM-32 scale scoring between the baseline visit and the visit at 6 months as endpoint., To evaluate the efficacy of metformin on locomotor function using the evolution of six minutes walking test scoring between the baseline visit, the visit at 6 months and the final visit at 12 months as endpoints., To evaluate the efficacy of metformin on hand-grip strength using the evolution of MyoGrip scoring between the baseline visit, the visit at 6 months and the final visit at 12 months as endpoints., To evaluate the efficacy of metformin on thumb-index pinch strength using the evolution of MyoPinch scoring between the baseline visit, the visit at 6 months and the final visit at 12 months as endpoints., To evaluate the efficacy of metformin on respiratory function using the evolution of supine vital capacity between the baseline visit, the visit at 6 months and the final visit at 12 months as endpoints., To evaluate the efficacy of metformin on quality of life using the evolution of QoLgNMD scoring between the baseline visit, the visit at 6 months and the final visit at 12 months as endpoints, To evaluate the efficacy of metformin on cardiac function using the evolution of left ventricular ejection fraction between the baseline visit and the final visit at 12 months as endpoints.

Source: https://euclinicaltrials.eu/ctis-public/view/2023-507660-39-00